EU clinical trial 2024-514166-40-00: A study to establish the bioequivalence of free acid tafamidis 61 mg capsule and tablet, and evaluate the safety and tolerability of the 61 mg tablet in healthy adults
Protocol code: B3461115
Sponsor: Pfizer Inc. (Pharmaceutical company). Phase: Human Pharmacology (Phase I)- Bioequivalence Study. Countries: Belgium (ended).
Therapeutic area(s): Diseases [C] - Pathological Conditions, Signs and Symptoms [C23]; Diseases [C] - Musculoskeletal Diseases [C05]
Gender: Female, Male. Age: 18-64 years, 65+ years. Enrolment: 22.
Status: Ended. Start date (EU): 2024-12-16. End date (EU): 2025-04-04. End date: 2025-04-05. Decision date: 2024-11-14. Results received: No. Last updated: 2024-12-06.
Decision dates by country: BE: 2024-12-06

Condition(s): Transthyretin amyloidosis

Source: https://euclinicaltrials.eu/ctis-public/view/2024-514166-40-00